EU clinical trial 2022-500488-10-00: AN OPEN-LABEL STUDY TO EVALUATE THE SAFETY AND PHARMACOKINETICS OF MIGALASTAT HCL IN SUBJECTS WITH FABRY DISEASE AND AMENABLE GLA VARIANTS AND SEVERE RENAL IMPAIRMENT OR END-STAGE RENAL DISEASE TREATED WITH HEMODIALYSIS
Protocol code: AT1001-025
Sponsor: Amicus Therapeutics Inc. (Pharmaceutical company). Phase: Therapeutic confirmatory (Phase III). Countries: Spain (ongoing, recruitment ended), France (ended), Portugal (ongoing, recruitment ended).
Therapeutic area(s): Diseases [C] - Nutritional and Metabolic Diseases [C18]
Gender: Female, Male. Age: 18-64 years, 65+ years. Enrolment: 5.
Start date (EU): 2022-12-19. Decision date: 2022-10-19. Results received: No. Last updated: 2026-01-28.
Decision dates by country: FR: 2022-10-19, PT: 2024-04-24, ES: 2022-10-21

Condition(s): Fabry Disease and Amenable GLA Variants and Severe Renal Impairment or Endstage Renal Disease Treated with Hemodialysis
Product: Galafold 123 mg hard capsules

Primary endpoint: Pharmacokinetic parameters and dosing confirmation will be estimated based on concentrations of migalastat in plasma and urine
Endpoint(s): Safety endpoints will include: adverse events, clinical laboratory parameters (serum chemistry, hematology, and urinalysis), eGFRMDRD and eGFRCKD-EPI, vital signs (blood pressure, HR, RR, and body temperature), 12-lead ECGs, physical examinations, Tolerability endpoints will include: treatment-emergent adverse events (incidence of SAEs, discontinuation due to AE, and severity of TEAE), PD endpoint will include change from baseline in plasma lyso-Gb3

Source: https://euclinicaltrials.eu/ctis-public/view/2022-500488-10-00